EU clinical trial 2024-510892-40-00: Clinical Outcome and Cost-effectiveness of Reduced Noradrenaline by Using a Lower Blood Pressure Target in Patients with Cardiogenic Shock from Acute Myocardial Infarction - NORshock
Protocol code: NL79416.018.21
Sponsor: Amsterdam UMC (Hospital/Clinic/Other health care facility). Phase: Therapeutic use (Phase IV). Countries: Netherlands (ongoing, recruiting), Denmark (ongoing, recruiting), Slovenia (ongoing, recruiting), Germany (ongoing, recruiting), Sweden (ongoing, recruiting), Belgium (ongoing, recruiting), Norway (ongoing, recruiting), Greece (ongoing, recruiting), Czechia (ongoing, recruiting).
Therapeutic area(s): Diseases [C] - Cardiovascular Diseases [C14]
Gender: Female, Male. Age: 18-64 years, 65+ years. Enrolment: 918.
Status: Ongoing, recruiting. Start date (EU): 2024-02-29. Decision date: 2024-02-19. Results received: No. Last updated: 2026-02-27.
Decision dates by country: NL: 2024-02-19, SI: 2024-09-06, GR: 2025-04-18, CZ: 2025-04-01, DE: 2024-08-22, NO: 2025-03-03, SE: 2024-09-16, DK: 2024-02-19, BE: 2025-04-17

Condition(s): Acute myocardial infarction complicated by cardiogenic shock
Product: NOREPINEPHRINE

Primary endpoint: The primary endpoint of the study is the composite of all-cause mortality and severe renal failure requiring renal replacement therapy within 30 days after randomization.
Endpoint(s): All-cause mortality at 30 days, Days alive and out of hospital (30 days)

Source: https://euclinicaltrials.eu/ctis-public/view/2024-510892-40-00